EU clinical trial 2024-511287-85-00: Randomized Double-Blind Placebo-Controlled Phase 3 Study to Evaluate the Efficacy and Safety of Maralixibat in the Treatment of Participants with Cholestatic Pruritus
Protocol code: MRX-802
Sponsor: Mirum Pharmaceuticals Inc. (Pharmaceutical company). Phase: Therapeutic confirmatory (Phase III). Countries: Italy (ongoing, recruitment ended), Spain (ongoing, recruitment ended), France (ongoing, recruitment ended), Poland (ongoing, recruitment ended), Germany (ongoing, recruitment ended).
Therapeutic area(s): Diseases [C] - Congenital, Hereditary, and Neonatal Diseases and Abnormalities [C16]
Gender: Female, Male. Age: 0-17 years, 18-64 years, 65+ years. Enrolment: 37.
Status: Ongoing, recruitment ended. Start date (EU): 2025-02-17. Decision date: 2024-10-09. Results received: No. Last updated: 2026-05-27.
Decision dates by country: DE: 2025-10-24, FR: 2024-10-09, IT: 2025-01-10, PL: 2025-01-11, ES: 2024-10-14

Condition(s): Cholestatic Pruritus
Product: Placebo, oral solution, Maralixibat chloride

Primary endpoint: Change in the average worst Observer-rated Itch-Reported Outcome (ItchRO[Obs]) severity score from baseline through Weeks 13–20. The baseline average worst ItchRO(Obs) score is defined as the 2-week average worst ItchRO(Obs) severity score prior to the first dose of the study drug, where the worst ItchRO(Obs) severity score is defined as the higher of the morning severity score and evening severity score.
Endpoint(s): Overall population: Change from baseline to average of Week (...) and Week (...) in total sBA (...), Overall population: Percentage of days through Weeks (...) with pruritus improvement (worst ItchRO(Obs) score <1 (...), (...): Change in the average worst-daily ItchRO(Obs) severity score from baseline through Weeks (...). The baseline average worst-daily ItchRO(Obs) score is defined as the (...)-week average worst-daily ItchRO(Obs) severity score prior to the first dose of the study drug., (...): Change from baseline to average of Week (...) and Week (...) in total sBA (...), (...): Percentage of days through Weeks (...) with pruritus improvement (worst-daily ItchRO[Obs] score <1 (...)

Source: https://euclinicaltrials.eu/ctis-public/view/2024-511287-85-00